EU clinical trial 2025-521051-23-00: Darolutamide with Bipolar Androgen Therapy (BAT) for Patients with Metastatic Castration Resistant Prostate Cancer (mCRPC) – the DaroBAT Trial
Protocol code: UniMS22_0022
Sponsor: Universitaet Muenster (Educational Institution). Phase: Therapeutic exploratory (Phase II). Countries: Germany (ongoing, recruiting).
Therapeutic area(s): Diseases [C] - Male Urogenital Diseases [C12]; Diseases [C] - Neoplasms [C04]
Gender: Male. Age: 18-64 years, 65+ years. Enrolment: 60.
Status: Ongoing, recruiting. Start date (EU): 2025-08-06. Decision date: 2025-07-24. Results received: No. Last updated: 2026-07-20.

Condition(s): metastatic castration-resistant prostate cancer
Product: ABIRATERONE, Testogel Dosiergel 16,2 mg/g Gel, DOCETAXEL, ENZALUTAMIDE, BAY 1841788, CABAZITAXEL

Primary endpoint: PFS defined as time from randomization to biochemical, clinical, or radiographic progression, or death from any cause, whichever occurs first., QoL until progression measured using the German version of the FACIT-F scale
Endpoint(s): 50% PSA response (PSA50) defined as a PSA decrease of ≥ 50% at any time compared to baseline value, Percentage of change in PSA from baseline to 12 weeks, Maximum decline in PSA that occurs at any point after start of treatment, Symptomatic progression-free survival defined as time from randomization to clinical progression or death from any cause, whichever occurs first., Overall Survival (OS) defined as time from randomization to death from any cause

Source: https://euclinicaltrials.eu/ctis-public/view/2025-521051-23-00